EU clinical trial 2024-518646-24-00: A randomized, double blind, double dummy, parallel group, multicenter clinical trial to evaluate the safety and clinical and microbiologic efficacy of oral fosfomycin calcium in adult womwn wiA th uUTI
Protocol code: EfFoCa2021
Sponsor: Asociacion Instituto De Investigacion Sanitaria Bioaraba, Laboratorios Ern S.A. (Laboratory/Research/Testing facility, Pharmaceutical company). Phase: Phase III and phase IV (Integrated). Countries: Spain (authorised, recruitment pending).
Therapeutic area(s): Diseases [C] - Bacterial Infections and Mycoses [C01]
Gender: Female. Age: 18-64 years, 65+ years. Enrolment: 384.
Status: Authorised, recruitment pending. Decision date: 2024-12-16. Results received: No. Last updated: 2025-06-13.

Condition(s): Uncomplicated urinary tract infection (uUTI)
Product: FOSFOMYCIN

Primary endpoint: Clinical (resolution of symptoms of uUTI) and microbiological response (bacterial pathogen reduced to <1000 CFU/mL in urine culture) in the microbiological -ITT population obtained at TOC VISIT
Endpoint(s): Proportion of subjects with continued clinical and microbiologic success assessed at Visit 1 (TOC visit)

Source: https://euclinicaltrials.eu/ctis-public/view/2024-518646-24-00